EU clinical trial 2023-509541-13-00: Lepidoglyphus destructor extract. Determination of in vivo allergenic potency in histamine equivalent prick testing units (HEP).
Protocol code: M603-STD-061
Sponsor: Inmunotek S.L. (Pharmaceutical company). Phase: Therapeutic exploratory (Phase II). Countries: Spain (ended).
Therapeutic area(s): Diseases [C] - Immune System Diseases [C20]
Gender: Female, Male. Age: 18-64 years. Enrolment: 30.
Status: Ended. Start date (EU): 2024-10-23. End date (EU): 2026-02-13. Decision date: 2024-08-14. Results received: Yes. Last updated: 2025-11-05.

Condition(s): Allergy to Lepidoglyphus destructor
Product: Prick test of Lepidoglyphus destructor extract, Skin Prick Test Positive control, Skin Prick Test Negative control

Primary endpoint: To assess the concentration of Lepidoglyphus destructor extract that induces a wheal of size equivalent to that produced by a 10 mg/mL histamine dihydrochloride solution.

Source: https://euclinicaltrials.eu/ctis-public/view/2023-509541-13-00